EU clinical trial 2024-516166-11-00: A Phase 1/2a/3 Evaluation of the Safety and Efficacy of Adding AL3818 (Anlotinib, INN: Catequentinib), a Dual Receptor Tyrosine Kinase Inhibitor, to Standard Platinum-Based Chemotherapy in Subjects with Recurrent or Metastatic Endometrial,Ovarian, Fallopian, Primary Peritoneal or Cervical Carcinoma.
Sponsor: Advenchen Laboratories LLC (Pharmaceutical company). Phase: Therapeutic confirmatory (Phase III). Countries: Spain (ended), Italy (ended).
Therapeutic area(s): Diseases [C] - Neoplasms [C04]
Gender: Female. Age: 18-64 years, 65+ years. Enrolment: 100.
Status: Ended. Start date (EU): 2022-06-06. End date (EU): 2025-03-31. Decision date: 2024-11-15. Results received: Yes. Last updated: 2024-11-19.
Decision dates by country: IT: 2024-11-19, ES: 2024-11-15

Condition(s): Platinum resistant recurrent or metastatic ovarian, fallopian, or primary peritoneal cancer

Primary endpoint: Progression Free Survival (PFS) is defined as the median number of months from the date of randomization until the first documented sign of disease progression or death due to any causes, whichever occurs earlier. PFS will be evaluated by a blinded independent radiological review (BICR).
Endpoint(s): Objective Tumor Response Rate (ORR) is defined as the proportion of subjects who achieve Complete Response (CR) or Partial Response (PR) as best responses according to RECIST 1.1. and duration of response. ORR will be evaluated by a blinded independent radiological review (BICR)., Duration of Response (DOR) is defined as median number of months from date of first documented objective response until first documented sign of disease progression or death due to any causes., Overall Survival (OS) is defined as the time from randomization until death from any cause.

Source: https://euclinicaltrials.eu/ctis-public/view/2024-516166-11-00